EU clinical trial 2025-523404-74-00: A Phase 2, Randomized, Double-Blind, Placebo-Controlled, Dose-Ranging Study of the Efficacy and Safety of ICP-332 in Participants with Prurigo Nodularis
Protocol code: ICP-CL-00609
Sponsor: Innocare Pharma Inc. (Pharmaceutical company). Phase: Therapeutic exploratory (Phase II). Countries: Belgium (authorised, recruitment pending), Poland (ongoing, recruiting), Germany (ongoing, recruiting), France (authorised, recruiting), Austria (authorised, recruiting).
Therapeutic area(s): Diseases [C] - Skin and Connective Tissue Diseases [C17]
Gender: Female, Male. Age: 18-64 years, 65+ years. Enrolment: 56.
Start date (EU): 2026-05-26. Decision date: 2026-05-13. Results received: No. Last updated: 2026-08-05.
Decision dates by country: PL: 2026-05-15, AT: 2026-05-17, BE: 2026-05-13, DE: 2026-05-15, FR: 2026-05-19

Condition(s): Prurigo Nodularis
Product: Placebo is identical with the test product and just does not contain active substance.

Primary endpoint: Percent change from baseline of weekly average in Peak pruritus-numeric rate scale (PP NRS) at Week 16.
Endpoint(s): Proportion of participants achieving ≥ 4-point improvement in PP NRS score (PP NRS ≥ 4) over time., Proportion of participants achieving Investigator's Global Assessment for Chronic Prurigo Stage scores of 0 or 1 (IGA-CPG-S 0/1) over time, Proportion of participants achieving both PP NRS ≥ 4 and IGA-CPG-S 0/1 over time., Percent change from baseline of weekly average in PP NRS over time., Change from baseline in Dermatology Life Quality Index (DLQI) score over time, Safety as assessed by the nature, severity, and incidence of adverse events (AEs); vital signs; electrocardiograms (ECGs); and clinical laboratory safety parameters., PK endpoints: Cmax, AUC, etc

Source: https://euclinicaltrials.eu/ctis-public/view/2025-523404-74-00